EU clinical trial 2024-512782-14-00: A Phase Ib/II, Multicentre, Double-blind, Randomised, Placebo-controlled, Dose Escalation and Dose-finding Study to Evaluate the Safety and Efficacy of IPN10200 in Improving the Appearance of Moderate to Severe Upper Facial Lines in Adults
Protocol code: D-FR-10200-002
Sponsor: Ipsen Innovation (Pharmaceutical company). Phase: Phase I and Phase II (Integrated)- First administration to humans. Countries: France (ongoing, recruiting), Germany (ongoing, recruiting).
Therapeutic area(s): Phenomena and Processes [G] - Physical Phenomena [G01]
Gender: Female, Male. Age: 18-64 years, 65+ years. Enrolment: 771.
Status: Ongoing, recruiting. Start date (EU): 2024-03-20. Decision date: 2024-07-16. Results received: No. Last updated: 2026-05-04.
Decision dates by country: DE: 2024-07-26, FR: 2024-07-16

Condition(s): Treatment of Moderate to Severe Upper Facial Lines
Product: IPN10200 placebo, DYSPORT 300 UNITES SPEYWOOD, poudre pour solution injectable, IPN10200

Primary endpoint: 1. Incidence of treatment emergent adverse events (TEAEs) at each dose At Stage 1/Step 1, Stage 3, 2. Incidence of serious adverse events (SAEs) at each dose At Stage 1/Step 1, Stage 3, 3. Incidence of Adverse Events (AEs) (or SAEs) leading to withdrawals and Adverse Events of Special Interest (AESIs) At Stage 1/Step 1, Stage 3, 4. Response to treatment At Stage 2 for the FHL group.Measured by the composite response of ≥ 2-grade improvement on Investigator’s Live Assessment (ILA) and subject’s self-assessment (SSA) at maximum contraction on the forehead lines:, 4. Measured by the composite response of ≥ 2-grade improvement on Investigator’s Live Assessment (ILA) and subject’s self-assessment (SSA) at maximum contraction on the forehead lines: ILA: a validated 4-point photographic scale to assess the severity and appearance of the Forehead Lines (FHL)s at maximum frown and at rest where 0 is “none” and 3 is “severe”, 4. Measured by the composite response of ≥ 2-grade improvement on Investigator’s Live Assessment (ILA) and subject’s self-assessment (SSA) at maximum contraction on the forehead lines: SSA: a validated 4-point categorical scale to assess the appearance of their FHLs at maximum frown where 0 is “no wrinkles” and 3 is “severe wrinkles”, 5. Response to treatment At Stage 2 for the glabellar lines (GL)+ FHL group. Measured by the composite response of ≥ 2-grade improvement on ILA and SSA at maximum contraction on the forehead lines (FHL) area: ILA: a validated 4-point photographic scale to assess the severity and appearance of the GLs and FHLs at maximum frown and at rest where 0 is “none” and 3 is “severe”, 5. Response to treatment At Stage 2 for the glabellar lines (GL)+ FHL group. Measured by the composite response of ≥ 2-grade improvement on ILA and SSA at maximum contraction on the forehead lines (FHL) area: SSA: a validated 4-point categorical scale to assess the appearance of their GLs and FHLs at maximum frown where 0 is “no wrinkles” and 3 is “severe wrinkles”, 6. Response to treatment At stage 2 for the LCL group. Measured by the composite response of ≥ 2-grade improvement ILA and SSA at maximum contraction on both sides of the lateral canthal lines (LCL) area: ILA: a validated 4-point photographic scale to assess the severity and appearance of the LCLs at maximum frown and at rest where 0 is “none” and 3 is “severe”, 6. Response to treatment At stage 2 for the LCL group. Measured by the composite response of ≥ 2-grade improvement ILA and SSA at maximum contraction on both sides of the lateral canthal lines (LCL) area: SSA: a validated 4-point categorical scale to assess the appearance of their LCLs at maximum frown where 0 is “no wrinkles” and 3 is “severe wrinkles”, 7. Percentage of Participants With Clinically Significant Changes from baseline in Vital Signs Double Blind phase. Clinically significant changes in vital signs will be reported. The clinical significance will be graded by the investigator., 8. Percentage of participants with clinically significant Change from baseline in 12-lead Electrocardiogram (ECG) readings Double Blind phase., 9. Percentage of participants with clinically significant change from baseline in facial and focused neurological/physical examination. Double Blind phase. Clinically significant changes in facial examination and focused neurological/physical examinations will be reported. The clinical significance will be graded by the investigator.
Endpoint(s): 1. Percentage of participants response to treatment for all stages. Measured by the composite response of ≥ 2-grade improvement on ILA and SSA for each concerned facial area in each respective stage (GL/LCL/FHL), 1. Measured by the composite response of ≥ 2-grade improvement on ILA and SSA for each concerned facial area in each respective stage (GL/LCL/FHL) ILA: a validated 4-point photographic scale to assess the severity and appearance of the GLs/LCLs/FHLs in each respective stage at maximum frown and at rest where 0 is “no lines are noticeable” and 3 is “lines are extremely pronounced”, 1. Measured by the composite response of ≥ 2-grade improvement on ILA and SSA for each concerned facial area in each respective stage (GL/LCL/FHL) SSA: a validated 4-point categorical scale to assess the appearance of their GLs/LCLs/FHLs in each respective stage at maximum frown where 0 is “no wrinkles” and 3 is “severe wrinkles”, 2. Percentage of participants response to treatment as measured by the reduction of ≥1 grade on the ILA at maximum contraction for each concerned facial area For all stages., 3. Percentage of pa rticipants with clinically significant change from baseline in facial and focused neurological/physical examination. Clinically significant changes in facial examination and focused neurological/physical examinations will be reported. The clinical significance will be graded by the investigator., 4. Percentage of participants response to treatment as achieved by a score of “none” or “mild” as measured by the ILA at rest For all stages., 5. Percentage of participants response to treatment as measured by the reduction of ≥1 grade on the SSA at maximum contraction for each concerned facial area For all stages, 6. Percentage of participants response to treatment as achieved by a score of “none” or “mild” as measured by the SSA at maximum contraction for each concerned facial area. S, 7. Percentage of participants response to treatment as achieved by a score of “very satisfied” or “satisfied” on the Subject Level of Satisfaction (SLS) for each concerned facial area. For all stages, 8. Duration of treatment response based on ILA and SSA at maximum contraction for each concerned facial area. For all stages, 9. Time to onset of treatment response based on subject diary cards to evaluate the appearance of their lines for each concerned facial area For all stages., 10. Satisfaction with facial appearance, measured by Facial Appearance Overall scale score on the Face-Q satisfaction scale. Stage 3., 10. Face Q is a participant-reported outcome instrument to evaluate the experience and outcomes of aesthetic facial procedures from the participant’s perspective. The Face Q instrument is composed of over 40 scales, covering four domains (Satisfaction with Facial Appearance, Health Related Quality of Life, Adverse Effects, and Process of Care)., 11. Satisfaction with facial appearance, measured by FACE-Q Short Form Facial Appearance scale score. Stage 3. The FACE-Q Short Form Facial Appearance scale is a participant-reported outcome instrument. It asks how dissatisfied or satisfied the participant is with their upper facial lines (UFL) (GL+FHL+LCL). The scale ranges from very dissatisfied to very satisfied., 12. Incidence, severity and nature of treatment emergent adverse events (TEAEs). All stages (except Stage 1/Step 1), 13. Incidence, severity and nature of serious adverse events (SAEs) All stages (except Stage 1/Step 1), 14. Incidence, severity and nature of Adverse Events (AEs) (or SAEs) leading to withdrawals and Adverse Events of Special Interest (AESIs) All stages (except Stage 1/Step 1), 15. Percentage of Participants With Clinically Significant Changes from baseline in Vital Signs. All stages (except Stage 1/Step 1) Clinically significant changes in vital signs will be reported. The clinical significance will be graded by the investigator, 16. Time between two consecutive injections. Stage 1/Step 3, 17. Percentage of participants with binding antibodies to IPN10200 Stage 1/Step 2, Stage 1/Step 3, Stage 2, and Stage 3, 18. Percentage of participants with neutralising antibodies to IPN10200 Stage 1/Step 2, Stage 1/Step 3, Stage 2, and Stage 3, 19. Percentage of participants with binding antibodies to BontA Stage 1/Step 2, Stage 1/Step 3, Stage 2, and Stage 3, 20. Percentage of participants with neutralising antibodies to BontA Stage 1/Step 2, Stage 1/Step 3, Stage 2, and Stage 3

Source: https://euclinicaltrials.eu/ctis-public/view/2024-512782-14-00